EU clinical trial 2023-509396-16-00: A Multicenter, Randomized, Double-Blind, Placebo-Controlled Phase III Study of Fuzuloparib Combined with Abiraterone Acetate and Prednisone (AA-P) versus Placebo Combined with AA-P as First-Line Treatment in Patients with Metastatic Castration-Resistant Prostate Cancer
Protocol code: SHR3162-III-305
Sponsor: Jiangsu Hengrui Pharmaceuticals Co. Ltd. (Pharmaceutical company). Phase: Therapeutic confirmatory (Phase III). Countries: Hungary (ongoing, recruitment ended), France (ongoing, recruitment ended), Poland (ongoing, recruitment ended), Belgium (ongoing, recruitment ended), Czechia (ongoing, recruitment ended), Spain (ongoing, recruitment ended).
Therapeutic area(s): Diseases [C] - Neoplasms [C04]
Gender: Male. Age: 18-64 years, 65+ years. Enrolment: 136.
Status: Ongoing, recruitment ended. Start date (EU): 2021-11-08. Decision date: 2024-03-19. Results received: No. Last updated: 2026-02-27.
Decision dates by country: HU: 2024-03-20, PL: 2024-03-25, CZ: 2024-03-21, FR: 2024-03-20, BE: 2024-03-21, ES: 2024-03-19

Condition(s): Metastatic Castration-Resistant Prostate Cancer
Product: Placebo, capsule, ZYTIGA 500 mg film-coated tablets, Prednison acis 5 mg, Tabletten, Fuzuloparib

Primary endpoint: -Cohort 1: rPFS (assessed by Blinded Independent Central Review [BICR] according to RECIST 1.1 and PCWG3 criteria) in unselected mCRPC subjects. - Cohort 2: rPFS (assessed by Blinded Independent Central Review [BICR] according to RECIST 1.1 and PCWG3 criteria) in mCRPC subjects harboring DRD.
Endpoint(s): OS in unselected mCRPC subjects (Cohort 1) and in mCRPC subjects harboring DRD (Cohort 2), respectively.

Source: https://euclinicaltrials.eu/ctis-public/view/2023-509396-16-00